EU clinical trial 2023-506663-33-00: A CHRONOBIOLOGICAL TREATMENT combining evening melatonin and morning light therapy IN IDIOPATHIC HYPERSOMNIA: a prospective, double bind, randomized, placebo-controlled -trial
Protocol code: 8443
Sponsor: Les Hopitaux Universitaires De Strasbourg (Hospital/Clinic/Other health care facility). Phase: Therapeutic exploratory (Phase II). Countries: France (ongoing, recruiting).
Therapeutic area(s): Diseases [C] - Nervous System Diseases [C10]; Not possible to specify
Gender: Female, Male. Age: 18-64 years. Enrolment: 72.
Status: Ongoing, recruiting. Start date (EU): 2024-09-07. Decision date: 2023-12-14. Results received: No. Last updated: 2025-03-26.

Condition(s): IDIOPATHIC HYPERSOMNIA
Product: Cellulose microcristalline, Mélatonine à libération immédiate

Primary endpoint: The primary endpoint is the difference in IHSS score before and after 6 weeks of active chronobiotherapy (2mg melatonin and BLT) or 6 weeks of placebo conditions (placebo drug and placebo light).

Source: https://euclinicaltrials.eu/ctis-public/view/2023-506663-33-00